EU clinical trial 2023-505925-15-00: Phase 1b/2, Multicenter, Open-label, Dose-Expansion Modular Study To Explore the Safety, Tolerability, and Anti-tumor Activity of HER3-DXd monotherapy and combinations in Patients with inoperable advanced breast cancer (ABC) after progression on T-DXd- (ICARUS BREAST 2)
Protocol code: 2023/3668
Sponsor: Institut Gustave Roussy (Hospital/Clinic/Other health care facility). Phase: Phase I and Phase II (Integrated)- First administration to humans. Countries: France (ongoing, recruiting).
Therapeutic area(s): Not possible to specify
Gender: Female, Male. Age: 18-64 years, 65+ years. Enrolment: 150.
Status: Ongoing, recruiting. Start date (EU): 2024-03-21. Decision date: 2024-01-10. Results received: No. Last updated: 2026-05-05.
Decision dates by country: FR: 2024-01-16

Condition(s): Patients with HER2-positive (HER2-pos) (cohort 1) or HER2-low defined as a score 1+ on immunohistochemistry [IHC] or as an IHC score 2+ and negative results on in situ hybridization (ISH) (cohort 2) ABC, and any hormone receptor (HR) status, who have progressed on trastuzumab deruxtecan (T-DXd). In addition to previous T-DXd, patients with HER2-pos tumors must have received prior treatment with trastuzumab (+/- pertuzumab) and taxanes and may have received T-DM1. Patients with HER2-low tumors must have received prior treatment with taxanes. Patients with HR-positive (HR+) and HER2-low tumor must have received prior treatment with endocrine therapy and CDK4/6 inhibitors.

Source: https://euclinicaltrials.eu/ctis-public/view/2023-505925-15-00